EU clinical trial 2022-502234-70-00: A PHASE III, RANDOMIZED, DOUBLE-BLIND, PLACEBO-CONTROLLED, MULTICENTER STUDY TO EVALUATE THE EFFICACY AND SAFETY OF ASTEGOLIMAB IN PATIENTS WITH CHRONIC OBSTRUCTIVE PULMONARY DISEASE
Protocol code: GB44332
Sponsor: F. Hoffmann-La Roche AG (Pharmaceutical company). Phase: Therapeutic confirmatory (Phase III). Countries: Hungary (ended), Greece (ended), Spain (ended), Denmark (ended), Sweden (ended), France (ended), Italy (ended), Netherlands (ended), Germany (ended), Austria (ended), Czechia (ended), Belgium (ended), Romania (ended), Bulgaria (ended), Poland (ended), Latvia (ended).
Therapeutic area(s): Diseases [C] - Respiratory Tract Diseases [C08]
Gender: Female, Male. Age: 18-64 years, 65+ years. Enrolment: 683.
Status: Ended. Start date (EU): 2023-07-14. End date (EU): 2025-07-09. Decision date: 2023-06-26. Results received: No. Last updated: 2025-08-26.
Decision dates by country: RO: 2023-07-03, AT: 2023-07-03, DK: 2023-06-26, IT: 2023-07-03, DE: 2023-06-30, BG: 2023-07-06, HU: 2023-06-29, LV: 2023-06-30, BE: 2023-06-28, FR: 2023-06-30, CZ: 2023-06-26, GR: 2023-06-30, PL: 2023-07-03, NL: 2023-07-03, ES: 2023-07-03, SE: 2023-06-29

Condition(s): Chronic Obstructive Pulmonary Disease (COPD)
Product: ASTEGOLIMAB, Astegolimab Placebo

Primary endpoint: Annualized rate of moderate and severe COPD exacerbations over the 52-week treatment period
Endpoint(s): Time to first moderate or severe COPD exacerbation during the 52-week treatment period, Absolute change from baseline in HRQoL at Week 52, as assessed through the SGRQ-C total score, Absolute change from baseline in post-bronchodilator FEV1 (liters) at Week 52, Absolute change from baseline in E-RS:COPD total score at Week 52, Proportion of participants with improvement in HRQoL, defined as a decrease from baseline of >= 4 points in SGRQ-C total score, at Week 52, Annualized rate of severe COPD exacerbations over the 52-week treatment period, Incidence and severity of all treatment-emergent adverse events (TEAE), including Serious Adverse Events (SAEs), adverse events of special interests (AESIs), and TEAEs leading to death or discontinuation, Change from baseline in selected vital signs, Change from baseline in selected clinical laboratory test results and electrocardiograms (ECGs), Serum concentration of astegolimab at specified timepoints, Prevalence of anti-drug antibodies (ADAs) at baseline and incidence of ADAs during the study, Annualized rate of moderate and severe COPD exacerbations over the 52-week treatment period

Source: https://euclinicaltrials.eu/ctis-public/view/2022-502234-70-00